EU clinical trial 2025-522653-19-00: (ASK-PD0-CS002) Long-Term Safety and Efficacy Follow-up of AB-1005 Gene Transfer Study Participants with Parkinson’s Disease or Multiple System Atrophy
Protocol code: ASK-PD0-CS002
Sponsor: Askbio Inc. (Pharmaceutical company). Phase: Therapeutic use (Phase IV). Countries: Poland (authorised, recruitment pending).
Therapeutic area(s): Diseases [C] - Nervous System Diseases [C10]
Gender: Female, Male. Age: 18-64 years, 65+ years. Enrolment: 40.
Status: Authorised, recruitment pending. Decision date: 2025-12-22. Results received: No. Last updated: 2026-03-26.

Condition(s): Multiple System Atrophy, Parkinson's Disease
Product: Fluorodopa (18F), AAV2-GDNF, Carbidopa

Primary endpoint: Incidence and severity of AEs (serious and non-serious)
Endpoint(s): For PD participants - Normalized PD motor diary times (Good ON, ON with troublesome dyskinesia, OFF), For PD participants - MDS-UPDRS part III (OFF and ON), For PD participants - MDS-UPDRS part II (OFF and ON), For PD participants - MDS-UPDRS part I, For PD participants - MDS-UPDRS part IV, For PD participants - Levodopa equivalent daily dose (LEDD), For PD participants - 18F-DOPA PET, For MSA participants - UMSARS parts I, II (ON), III, IV, For MSA participants - MSA-QoL

Source: https://euclinicaltrials.eu/ctis-public/view/2025-522653-19-00